EU clinical trial 2026-525987-16-00: The headache- and migraine-inducing effects of apremilast in women with migraine without aura
Sponsor: Syddansk Universitet (University of Southern Denmark) (Educational Institution). Phase: Phase I and Phase II (Integrated)- Other. Countries: Denmark (authorised, recruitment pending).
Therapeutic area(s): Diseases [C] - Nervous System Diseases [C10]
Gender: Female. Age: 18-64 years. Enrolment: 14.
Status: Authorised, recruitment pending. Decision date: 2026-07-01. Results received: No. Last updated: 2026-07-01.

Condition(s): Migraine without aura
Product: Apremilast STADA 30 mg, filmomhulde tabletten, Lactose monohydrate

Primary endpoint: Difference in the occurrence of migraine-like attacks between apremilast- and placebo-treated women with migraine without aura during the entire observational period (until 12 hours post-administration)
Endpoint(s): Difference in headache intensities over time between apremilast- and placebo-treated women with migraine without aura during the entire observational period (until 12 hours post-administration), The occurrence of any headache, irrespective of migraine criteria, between apremilast- and placebo-treated women with migraine without aura during the entire observational period (until 12 hours post-administration), Difference in heart rate and mean arterial pressure (MAP) until 90 minutes post-administration between apremilast- and placebo-treated women with migraine without aura, Difference in the incidence of adverse events during the entire observational period (until 12 hours post-administration) between apremilast- and placebo-treated women with migraine without aura

Source: https://euclinicaltrials.eu/ctis-public/view/2026-525987-16-00